EU clinical trial 2024-513374-22-00: A DOUBLE-BLIND PHASE 3 EXTENSION TRIAL ASSESSING THE LONG TERM SAFETY AND EFFICACY OF GLEPAGLUTIDE IN PATIENTS WITH SHORT BOWEL SYNDROME (SBS)
Protocol code: ZP1848-17127
Sponsor: Zealand Pharma A/S (Pharmaceutical company). Phase: Therapeutic confirmatory (Phase III). Countries: France (ended), Belgium (ended), Germany (ended), Netherlands (ended), Poland (ended).
Therapeutic area(s): Diseases [C] - Digestive System Diseases [C06]
Gender: Female, Male. Age: 18-64 years, 65+ years. Enrolment: 77.
Status: Ended. Start date (EU): 2019-04-30. End date (EU): 2026-03-24. End date: 2026-03-25. Decision date: 2024-11-13. Results received: No. Last updated: 2025-10-15.
Decision dates by country: BE: 2024-11-13, NL: 2024-11-13, DE: 2024-11-13, FR: 2024-12-23, PL: 2024-11-24

Condition(s): Short Bowel Syndrome
Product: Glepaglutide 20.0 mg/mL, Glepaglutide Placebo

Primary endpoint: Safety Endpoints: Incidence and type of AEs (primary endpoint), Safety Endpoints: Incidence and type of serious adverse events (SAEs) and AESIs., Safety Endpoints: Changes from baseline in: - Vital signs -Electrocardiogram (ECG), Safety Endpoints: Changes from baseline in: -Hematology -Biochemistry -Urinalysis, Safety Endpoints: Immunogenicity, Efficacy Endpoints: Reduction in weekly PS volume from baseline, Efficacy Endpoints:Reduction of at least 20% in weekly PS volume from baseline, Efficacy Endpoints: Reduction in days on PS ≥ 1 day/week from baseline, Efficacy Endpoints: Reduction in weekly PS volume of 100% (weaned off)
Endpoint(s): Change in fluid composite effect (FCE) from baseline, Reduction in calculated energy content of parenteral macronutrients from baseline, Reduction in number of days on PS per week from baseline, Reduction of at least 40% in weekly PS volume from baseline, Change in weight from baseline

Source: https://euclinicaltrials.eu/ctis-public/view/2024-513374-22-00